EU clinical trial 2023-503357-35-00: A Multicentre, Phase II, Single-Arm, Interventional Study of Neoadjuvant Durvalumab and Platinum-Based Chemotherapy (CT), followed by either Surgery and Adjuvant Durvalumab or Chemoradiotherapy (CRT) and consolidation Durvalumab, in participants with Resectable or Borderline Resectable Stage IIB-IIIB Non-Small Cell Lung Cancer (NSCLC)
Protocol code: D9106C00002
Sponsor: AstraZeneca AB (Pharmaceutical company). Phase: Therapeutic exploratory (Phase II). Countries: Germany (ongoing, recruitment ended), Italy (ongoing, recruitment ended), Portugal (ongoing, recruitment ended), Spain (ongoing, recruitment ended), Czechia (ongoing, recruitment ended), Austria (ongoing, recruitment ended), Hungary (ongoing, recruitment ended), France (ongoing, recruitment ended), Sweden (ongoing, recruitment ended).
Therapeutic area(s): Diseases [C] - Neoplasms [C04]
Gender: Female, Male. Age: 18-64 years, 65+ years. Enrolment: 124.
Status: Ongoing, recruitment ended. Start date (EU): 2024-03-20. Decision date: 2024-02-13. Results received: No. Last updated: 2026-07-24.
Decision dates by country: CZ: 2024-02-13, IT: 2024-02-14, SE: 2024-05-24, PT: 2024-02-15, HU: 2024-02-16, DE: 2024-02-13, FR: 2024-02-16, AT: 2024-04-29, ES: 2024-05-03

Condition(s): Non-small Cell Lung Cancer (NSCLC)
Product: PEMETREXED, GEMCITABINE, VINORELBINE, CARBOPLATIN, Inflectra 100 mg powder for concentrate for solution for infusion, Micofenolato de mofetil Generis 250 mg Cápsulas, PACLITAXEL, CISPLATIN, DOCETAXEL, IMFINZI 50 mg/mL concentrate for solution for infusion.

Primary endpoint: Resection rate defined as the proportion of all participants who underwent definitive surgery. The analysis will be performed in all participants who received at least one dose of study intervention (FAS).
Endpoint(s): Resection rate as defined above. The analysis will be performed in the subset of the FAS assessed as resectable at baseline, Resection rate as defined above. The analysis will be performed in the subset of the FAS assessed as borderline resectable at baseline., R0 resection rate. The analysis will be performed in a subgroup of the FAS who underwent definitive surgery. R1 resection rate. The analysis will be performed in a subgroup of the FAS who underwent definitive surgery. R2 resection rate. The analysis will be performed in a subgroup of the FAS who underwent definitive surgery, pCR defined as the proportion of participants who undergo surgery and have 0% residual viable tumour cells in resected lung and lymph nodes. The analysis will be performed in the Resectable Participants Cohort (ie, participants in the FAS who are deemed resectable after MDT re-assessment), OS defined as the time from first dose of study intervention until the date of death due to any cause. Median OS, OS12, and OS24. The analysis will be performed in the FAS, Resectable Participants Cohort, and Unresectable Participants Cohort (ie, participants in the FAS who are deemed unresectable after MDT reassessment, EFS defined as the time from the first dose of study intervention to any of the following events: PD that precludes surgery, progression or recurrence of disease after surgery, PD in the absence of surgery, or death due to any cause. Median EFS, EFS12, and EFS24. The analysis will be performed in the FAS and the Resectable Participants Cohort., PFS defined as the time from the first dose of study intervention to RECIST 1.1-defined PD, as assessed by the investigator, or death due to any cause. Median PFS, PFS12, and PFS24. The analysis will be performed in the Unresectable Participants Cohort., ORR defined as the proportion of participants who have unconfirmed CR or PR, pre-surgery/pre-CRT as assessed by the investigator per RECIST 1.1. The analysis will be performed in the Resectable Participants Cohort and Unresectable Participants Cohort., ORR defined as the proportion of participants treated with definitive CRT who have unconfirmed CR or PR, at first assessment after CRT completion as assessed by the investigator per RECIST 1.1. The analysis will be performed in the Unresectable Participants Cohort., ctDNA clearance (ie, complete molecular response, cMR, defined as the proportion of participants with a change from detectable ctDNA to undetectable ctDNA). ctDNA clearance will be assessed from baseline (pre-neoC1D1) to pre-surgery/pre-CRT, and the analysis will be performed in the FAS (biomarkerevaluable participants only)., Safety and tolerability will be evaluated in terms of AEs, including PRAEs, AESIs, imAEs, SAEs, surgeryrelated AEs, fatal AEs precluding surgery, deaths within 90 days after surgery, and AEs resulting in treatment interruption and discontinuation (assessment of incidence, severity, nature, seriousness, intervention/treatment, outcome, and causality), vital signs, clinical laboratory assessments, and ECGs. The analysis will be performed in the FAS (all participants who received at least, Time from last neoadjuvant dose to surgery. Participants with delayed surgery, length and reason of surgical delay. Intended surgical approach at baseline. Actual surgical approach. Intended surgical procedure at baseline. Actual surgical procedure. Duration of surgical procedure. Length of post-operative hospital stay. The analysis will be performed in a subgroup of the FAS who underwent definitive surgery

Source: https://euclinicaltrials.eu/ctis-public/view/2023-503357-35-00